EU clinical trial 2025-520897-21-00: A Phase 2/3, Multicenter, Randomized, Open-Label Study Evaluating the Efficacy and Safety of Etentamig and Daratumumab (Etentamig+D) Compared to Daratumumab, Lenalidomide, and Dexamethasone (DRd) in Subjects with Newly Diagnosed Multiple Myeloma Not Eligible for Transplant
Protocol code: M25-586
Sponsor: AbbVie Deutschland GmbH & Co. KG (Pharmaceutical company). Phase: Phase II and Phase III (Integrated). Countries: Norway (authorised, recruitment pending), France (ongoing, recruiting), Spain (ongoing, recruiting).
Therapeutic area(s): Diseases [C] - Neoplasms [C04]
Gender: Female, Male. Age: 18-64 years, 65+ years. Enrolment: 24.
Start date (EU): 2026-02-25. Decision date: 2026-02-18. Results received: No. Last updated: 2026-04-16.
Decision dates by country: ES: 2026-02-18, NO: 2026-02-18, FR: 2026-02-18

Condition(s): Multiple Myeloma
Product: DARATUMUMAB, LENALIDOMIDE, DEXAMETHASONE, LENALIDOMIDE, LENALIDOMIDE, Etentamig, DEXAMETHASONE, LENALIDOMIDE, LENALIDOMIDE, LENALIDOMIDE

Primary endpoint: Phase 2: Clinical activity as determined by International Myeloma Working Group (IMWG (2016) response rates [Overall Response Rate (ORR), Complete Response (CR) or better, Very Good Partial Response (VGPR), Partial Response (PR)], Phase 3: Minimal Residual Disease (MRD) negative CR rate, Phase 3: Progression-Free Survival (PFS)
Endpoint(s): Phase 2: MRD negative CR rate, Phase 2: PFS, Phase 2: Sustained MRD negativity rate (12 months), Phase 2: Overall Survival (OS), Phase 2: Safety and Tolerability, Phase 2: Maximum Observed Serum Concentration (Cmax), Phase 2: Time to Cmax (time to maximum observed concentration, Tmax), Phase 2: Area Under the Serum Concentration-Time Curve (AUC), Phase 2: Positive or negative anti-drug antibodies (ADAs) and neutralizing anti-drug antibodies (NAbs), Phase 3: OS, Phase 3: Sustained MRD negativity rate (12 months), Phase 3: Rate of ≥ CR, Phase 3: Rate of ≥ VGPR or better, Phase 3: ORR, Phase 3: Time to Response (TTR), Phase 3: Duration of Response (DOR), Phase 3: Time-to-progression (TTP), Phase 3: Duration of Response (DOR), Phase 3: Time-to-progression (TTP), Phase 3: Event Free Survival (EFS), Phase 3: Progression-Free Survival on Subsequent Therapy (PFS2), Phase 3: Safety and tolerability, Phase 3: Change from baseline in European Organization for Research and Treatment of Cancer Quality of Life Questionnaire (EORTC QLQ-C30) Physical Functioning score, Phase 3: Change from baseline in EORTC QLQ-C30 Global Health Status/QoL score, Phase 3: Change from baseline and time to deterioration in the remaining scales and items of EORTC QLQ-C30, Phase 3: Symptomatic AEs as assessed by the Patient-Reported Outcomes version of the Common Terminology Criteria for Adverse Events (PRO-CTCAE), Phase 3: Overall bother due to treatment side effects as assessed by the Functional Assessment of Cancer Therapy-General (FACT-G) GP5, Phase 3: Change from baseline in Patient Global Impression of Severity (PGIS) scores, Phase 3: Change from baseline in European Quality of Life 5 Dimensions (EQ-5D-5L) scores

Source: https://euclinicaltrials.eu/ctis-public/view/2025-520897-21-00